EU clinical trial 2025-523868-20-00: Efficacy and safety of a novel dual pH-dependent delayed-release ColeseveLam for the trEatment of bile Acid diarrhoea: a Randomized, double-blind, parallel-group, placebo-controlled clinical trial - CLEAR
Protocol code: F106-CT01
Sponsor: Monteresearch S.r.l. (Pharmaceutical company). Phase: Therapeutic exploratory (Phase II). Countries: Italy (authorised, recruitment pending).
Therapeutic area(s): Diseases [C] - Digestive System Diseases [C06]
Gender: Female, Male. Age: 18-64 years, 65+ years. Enrolment: 50.
Status: Authorised, recruitment pending. Decision date: 2026-04-02. Results received: No. Last updated: 2026-06-11.
Decision dates by country: IT: 2026-06-11

Condition(s): Bile acid diarrhoea
Product: SUB01423MIG, DISSENTEN 2 mg compresse, Colesevelam-matching placebo film-coated oral tablets (Unit Dose D)., Colesevelam-matching placebo film-coated oral tablets (Unit Dose C)., SUB01423MIG

Primary endpoint: Primary efficacy endpoint: Proportion of participants with BAD remission, defined according to Hjortswang criteria, at the end of the stable dose treatment period (Days 6-12), considering participants with moderate-to-severe BAD defined by 75SeHCAT ≤10%.
Endpoint(s): Secondary efficacy endopoints: Proportion of participants with BAD remission, as per Hjortswang criteria, at the end of the stable dose treatment period, considering the subgroup of participants with BAD defined by C4 >46 ng/mL., Secondary efficacy endpoints: Change from screening/baseline period (i.e., Days -8 to -2) to stable dose treatment period (i.e., Days 6-12) in the mean number of stools/day with a BSFS type ≤2, ≥3 and ≤5, and ≥6, as self-assessed daily by participants up to End of Study (EOS) (e-diary), considering participants with BAD defined by either 75SeHCAT or C4 criteria., Secondary efficacy endpoints: Change from screening/baseline period (Days -8 to -2) to stable dose treatment period (Days 6-12) in the average BSFS score, as self-assessed daily by participants up to EOS (e-diary), considering participants with BAD defined by either 75SeHCAT or C4 criteria., Secondary efficacy endpoints: Change from screening/baseline period (Days -8 to -2) to stable dose treatment period (Days 6-12) in the mean number of stools/day (average daily frequency of defecation), as self-assessed daily by participants up to EOS (e-diary), considering participants with BAD defined by either 75SeHCAT or C4 criteria., Secondary efficacy endpoints: Change from screening/baseline period (Days -8 to -2) to stable dose treatment period (Days 6-12) in the mean number of CSBM, defined as the spontaneous occurrence of a bowel movement associated with a feeling of complete evacuation, as self-assessed daily by participants up to EOS (e-diary), considering participants with BAD defined by either 75SeHCAT or C4 criteria., Secondary efficacy endpoints: Change from screening/baseline period (Days -8 to -2) to stable dose treatment period (Days 6-12) in the average score for urgency of defecation, as self-assessed daily by participants up to EOS, using a 7-point Likert scale (ranging from 0 to 6, where 0 = no urgency at all and 6 = a very great deal of urgency) (e-diary)., Secondary efficacy endpoints: Change from baseline/randomization at End of Treatment (EOT) in the average total score for the Gastrointestinal Symptom Rating Scale (GSRS), as well as the relative scores for each symptom cluster (i.e., reflux, abdominal pain, indigestion, diarrhoea and constipation) and single item, as self-assessed by participants (e-diary)., Secondary efficacy endpoints: Proportion of participants who use the rescue medication., Exploratory efficacy endpoint: Change from baseline/randomization at EOT of serum concentration of C4., Safety and tolerability endpoints: Incidence of all Adverse Events (AEs), AEs leading to IMP discontinuation, Adverse Drug Reactions (ADRs), and Serious Adverse Events (SAEs) throughout the trial., Safety and tolerability endpoints: Vital signs (systolic and diastolic blood pressure, and heart rate) at Visit 1, Visit 2, EOT and EOS., Safety and tolerability endpoints: Safety laboratory evaluations at Visit 1 and EOT.

Source: https://euclinicaltrials.eu/ctis-public/view/2025-523868-20-00